EU clinical trial 2025-521082-26-00: A Randomized Open-Label, Parallel-Group, Phase 2, 2-Arm Study to Investigate the Pharmacokinetic Profiles of Midazolam Subcutaneous Injection Compared with Midazolam Intravenous Injection in Adult Male and Female Terminally Ill Patients
Protocol code: AHUS_PAL_25_01
Sponsor: Akershus University Hospital (Hospital/Clinic/Other health care facility). Phase: Therapeutic exploratory (Phase II). Countries: Norway (authorised, recruitment pending).
Therapeutic area(s): Diseases [C] - Neoplasms [C04]
Gender: Female, Male. Age: 18-64 years, 65+ years. Enrolment: 30.
Status: Authorised, recruitment pending. Decision date: 2025-06-13. Results received: No. Last updated: 2025-06-13.

Condition(s): Terminal illness requiring palliative care, with indications for parenteral midazolam administration for symptom management (e.g., anxiety, restlessness, agitation, and dyspnea).
Product: Midazolam B. Braun 1 mg/ml injeksjons-/infusjonsvæske, oppløsning, Midazolam B. Braun 1 mg/ml injeksjons-/infusjonsvæske, oppløsning

Primary endpoint: AUC0-90 of midazolam based on serum samples collected at 2, 5, 7, 10, 12, 15, 20, 25, 30, 40, 50, 60, 75, and 90 minutes post-administration.
Endpoint(s): Tmax, Cmax of midazolam and 1-OH-midazolam, AUC0-90 for 1-OH-midazolam, Metabolic ratio: AUC0-90 (1-OH-midazolam / midazolam)., Injection site discomfort (pain, redness, swelling, itching)., Change in respiratory rate from baseline at 10, 20, 30, 40, 50, 60, 75, and 90 minutes, Change in oxygen saturation from baseline at 10, 20, 30, 40, 50, 60, 75, and 90 minutes, Change in RASS-PAL score from baseline at 10, 20, 30, 40, 50, 60, 75, and 90 minutes, Time and number of repeated administrations of sedative medication within 90 minutes following study drug injection

Source: https://euclinicaltrials.eu/ctis-public/view/2025-521082-26-00